EU clinical trial 2024-520081-65-00: Phase II, clinical trial, to evaluate OS in two cohorts in relapsed stage III non-small-cell lung cancer (NSCLC) pretreated with chemoradiotherapy and durvalumab
Protocol code: CONDOR
Sponsor: Fondazione Ricerca Traslazionale (Laboratory/Research/Testing facility). Phase: Therapeutic exploratory (Phase II). Countries: Italy (authorised, recruitment pending).
Therapeutic area(s): Diseases [C] - Neoplasms [C04]
Gender: Female, Male. Age: 18-64 years, 65+ years. Enrolment: 75.
Status: Authorised, recruitment pending. Decision date: 2025-02-20. Results received: No. Last updated: 2026-02-20.

Condition(s): NSCLC non-small cell lung cancer
Product: IMFINZI 50 mg/mL concentrate for solution for infusion.

Primary endpoint: Overall survival (OS) in Cohort A and in Cohort B
Endpoint(s): The secondary endpoints are as follows: • progression-free survival (PFS) in Cohort A and in Cohort B; • objective response rate (ORR) in Cohort A and in Cohort B; • safety and incidence of AEs in each Cohort according to treatment; • PFS and overall survival (OS) according to biomarkers (i.e., PD-L1, ERCC1, SLFN11, STK11, KEAP1, p53 expression, DNA repair genes [including BRCA 1-2 mutations] and tumor mutational burden).

Source: https://euclinicaltrials.eu/ctis-public/view/2024-520081-65-00